EU clinical trial 2022-501074-19-00: Randomised, double-blind, placebo-controlled, Phase IIb/Phase III study to evaluate the efficacy and safety of spesolimab in patients with moderate to severe hidradenitis suppurativa. Lunsayil 1.
Protocol code: 1368-0098
Sponsor: Boehringer Ingelheim International GmbH, Boehringer Ingelheim Espana S.A., Boehringer Ingelheim RCV GmbH & Co. KG (Pharmaceutical company). Phase: Phase II and Phase III (Integrated). Countries: Czechia (ended), Germany (ended), Portugal (ended), Austria (ended), Spain (ended), France (ended), Belgium (ended), Slovakia (ended), Greece (ended), Bulgaria (ended), Netherlands (ended), Lithuania (ended), Poland (ended), Norway (ended), Denmark (ended), Italy (ended), Finland (ended).
Therapeutic area(s): Diseases [C] - Bacterial Infections and Mycoses [C01]; Diseases [C] - Skin and Connective Tissue Diseases [C17]
Gender: Female, Male. Age: 18-64 years, 65+ years. Enrolment: 89.
Status: Ended. Start date (EU): 2023-10-13. End date (EU): 2025-03-31. End date: 2025-04-01. Decision date: 2023-05-22. Results received: Yes. Last updated: 2025-05-13.
Decision dates by country: LT: 2023-05-25, ES: 2023-05-23, FR: 2023-05-25, DE: 2023-05-26, BE: 2023-05-22, SK: 2023-05-22, BG: 2023-05-29, GR: 2023-05-23, PL: 2023-05-29, AT: 2023-05-30, IT: 2023-05-24, CZ: 2023-05-24, FI: 2023-05-24, NL: 2023-05-23, DK: 2023-05-22, PT: 2024-08-13, NO: 2024-08-07

Condition(s): Hidradenitis suppurativa
Product: Placebo for BI 655130 (solution for injection), Spesolimab, Placebo for BI 655130 (solution for infusion)

Primary endpoint: Percent change from baseline in dT count.

Source: https://euclinicaltrials.eu/ctis-public/view/2022-501074-19-00